EU clinical trial 2024-512736-29-00: An Open-Label Pilot Study of Losmapimod to Evaluate the Safety, Tolerability, and Changes in Biomarker and Clinical Outcome Assessments in Subjects With Facioscapulohumeral Muscular Dystrophy 1 (FSHD1) with Extension
Protocol code: FIS-001-2019
Sponsor: Fulcrum Therapeutics Inc. (Pharmaceutical company). Phase: Therapeutic exploratory (Phase II). Countries: Netherlands (ended).
Therapeutic area(s): Diseases [C] - Musculoskeletal Diseases [C05]; Diseases [C] - Nervous System Diseases [C10]
Gender: Female, Male. Age: 18-64 years, 65+ years. Enrolment: 14.
Status: Ended. Start date (EU): 2019-08-23. End date (EU): 2024-10-31. End date: 2024-11-01. Decision date: 2024-06-11. Results received: Yes. Last updated: 2024-06-11.

Condition(s): Facioscapulohumeral Muscular Dystrophy 1 (FSHD1)
Product: Losmapimod

Primary endpoint: Safety and tolerability based on AEs, clinical laboratory test results, ECGs, and vital signs.

Source: https://euclinicaltrials.eu/ctis-public/view/2024-512736-29-00